EU clinical trial 2023-510032-37-00: Phase I/II/III Gene Transfer Clinical Trial of scAAV9.U1a.hSGSH for Mucopolysaccharidosis (MPS) IIIA
Protocol code: ABT-001
Sponsor: Ultragenyx Pharmaceutical Inc. (Pharmaceutical company). Phase: Phase I and Phase II (Integrated)- First administration to humans. Countries: Spain (ongoing, recruiting).
Therapeutic area(s): Diseases [C] - Congenital, Hereditary, and Neonatal Diseases and Abnormalities [C16]
Gender: Female, Male. Age: 0-17 years. Enrolment: 21.
Status: Ongoing, recruiting. Start date (EU): 2017-04-18. Decision date: 2024-02-07. Results received: No. Last updated: 2026-08-04.

Condition(s): Mucopolysaccharidosis type IIIA
Product: ABO-102, ABO-102, ABO-102

Primary endpoint: Safety: Incidence of treatment-emergent adverse events (TEAEs) and treatment-emergent serious adverse events (SAEs), Efficacy: Cerebrospinal fluid (CSF) heparan sulfate (HS) (disaccharide) exposure
Endpoint(s): Bayley Scales of Infant and Toddler Development–Third edition (BSITD- III) Cognitive raw score, CSF ganglioside type 2 (GM2) exposure, CSF ganglioside type 3 (GM3) exposure, CSF HS percentage change from baseline, BSITD-III Receptive Communication raw score, BSITD-III Expressive Communication raw score, Total cortical volume (cm 3) percentage change from baseline

Source: https://euclinicaltrials.eu/ctis-public/view/2023-510032-37-00